EU clinical trial 2022-502184-38-00: A Randomized, Double-Blind, Placebo-Controlled Study of Intravenously Administered ALE.F02 to Evaluate the Safety, Tolerability, Pharmacokinetics, and Renal Sparing in Antineutrophil Cytoplasmic Antibody Associated Vasculitis With Rapidly Progressive Glomerulonephritis
Protocol code: ALE.F02.03
Sponsor: Alentis Therapeutics AG (Pharmaceutical company). Phase: Therapeutic exploratory (Phase II). Countries: Czechia (ongoing, recruiting), Germany (ongoing, recruiting), Italy (ongoing, recruiting), Spain (ongoing, recruiting), Denmark (ongoing, recruiting), France (ongoing, recruiting), Sweden (ongoing, recruiting).
Therapeutic area(s): Diseases [C] - Immune System Diseases [C20]
Gender: Female, Male. Age: 18-64 years, 65+ years. Enrolment: 51.
Status: Ongoing, recruiting. Start date (EU): 2025-06-06. Decision date: 2023-07-05. Results received: No. Last updated: 2026-06-01.
Decision dates by country: CZ: 2023-07-10, DK: 2023-07-05, ES: 2023-07-05, IT: 2023-07-07, SE: 2023-07-06, FR: 2023-07-05, DE: 2023-07-05

Condition(s): Rapidly progressive glomerulonephritis
Product: RITUXIMAB, Test IMP (ALE.F02) without active substance, LIXUDEBART, CYCLOPHOSPHAMIDE

Primary endpoint: The primary endpoint for this study is the safety and tolerability of ALE.F02 when administered as a continuous IV infusion in patients with RPGN attributed to AAV. Safety endpoints are the following: - All AEs; - All SAEs; - Hematology and clinical chemistry analyte assessments; - Serum lipids; - Antidrug antibodies (ADAs); and - ECGs.
Endpoint(s): 1. The key secondary endpoint for this study is the change in mean eGFR from baseline to Week 24/EOT for recipients of ALE.F02 compared to placebo., 2. Change in mean urine protein to creatinine ratio (UPCR) AUC from baseline to Week 24/EOT and Week 52/EOS for recipients of ALE.F02 compared to placebo;, 3. Time to stable proteinuria (≤0.5 g/day for ≥14 days) during the Treatment Period for recipients of ALE.F02 compared to placebo;, 4. Time to stable hematuria (≤5 RBCs/high-power field for ≥14 days) during the Treatment Period for recipients of ALE.F02 compared to placebo;, 5. Incidence of RRT at any time during the study for recipients of ALE.F02 compared to placebo; and, 6. Total glucocorticoid and immunosuppressive exposure at Week 24/EOT and Week 52/EOS for recipients of ALE.F02 compared to placebo.

Source: https://euclinicaltrials.eu/ctis-public/view/2022-502184-38-00